EU clinical trial 2024-518042-24-00: An open label signal detection study to evaluate the effects of cariprazine on cognitive functioning in patients with schizophrenia in need of adjustment of oral antipsychotic treatment
Protocol code: CariCog
Sponsor: Medizinische Universitaet Innsbruck (Educational Institution). Phase: Therapeutic use (Phase IV). Countries: Austria (ongoing, recruiting).
Therapeutic area(s): Psychiatry and Psychology [F] - Mental Disorders [F03]
Gender: Female, Male. Age: 18-64 years, 65+ years. Enrolment: 20.
Status: Ongoing, recruiting. Start date (EU): 2021-03-21. Decision date: 2024-10-29. Results received: No. Last updated: 2026-06-22.

Condition(s): schizophrenia
Product: Reagila 1.5 mg hard capsules

Primary endpoint: To investigate changes in the BACS and HFERST scores and in fMRI data from baseline to week 28
Endpoint(s): Longitudinal changes in the following measures: 1. PANSS 2. NSA-4 3. CGI 4. CDRS 5. SHRS/SMARTS 6. MARS 7. PSP 8. EQ-5D

Source: https://euclinicaltrials.eu/ctis-public/view/2024-518042-24-00